EU clinical trial 2024-520328-27-00: J1R-MC-GZFD: A Parallel-Group Treatment, Phase 2, Double-Blind study of Once-Weekly Subcutaneous LY3457263 Compared to Placebo in Participants with Type 2 Diabetes Mellitus on a Stable Dose of Semaglutide or Tirzepatide who Failed to Achieve HbA1c Goal
Protocol code: J1R-MC-GZFD
Sponsor: Eli Lilly & Co. (Pharmaceutical company). Phase: Therapeutic exploratory (Phase II). Countries: Germany (ongoing, recruiting), Poland (ongoing, recruiting).
Therapeutic area(s): Diseases [C] - Nutritional and Metabolic Diseases [C18]
Gender: Female, Male. Age: 18-64 years. Enrolment: 59.
Status: Ongoing, recruiting. Start date (EU): 2025-08-07. Decision date: 2025-07-04. Results received: No. Last updated: 2026-07-07.
Decision dates by country: DE: 2025-07-04, PL: 2025-07-28

Condition(s): Type 2 Diabetes
Product: Tirzepatide, Tirzepatide, placebo to match LY, Tirzepatide, Tirzepatide, Tirzepatide, Nisotirotide

Primary endpoint: Change from Baseline in Hemoglobin A1c (HbA1c) [Time Frame: Baseline, Week 24]

Source: https://euclinicaltrials.eu/ctis-public/view/2024-520328-27-00